EU clinical trial 2024-512343-23-00: A Phase 2a, multicenter, randomized, double-blind, placebo-controlled study to evaluate safety, tolerability, pharmacodynamic markers, and pharmacokinetics of AP-101 in patients with familial amyotrophic lateral sclerosis (fALS) and sporadic amyotrophic lateral sclerosis (sALS)
Protocol code: AP101-02
Sponsor: AL-S Pharma AG (Pharmaceutical company). Phase: Therapeutic exploratory (Phase II). Countries: Sweden (ended).
Therapeutic area(s): Diseases [C] - Nervous System Diseases [C10]
Gender: Female, Male. Age: 18-64 years, 65+ years. Enrolment: 5.
Status: Ended. Start date (EU): 2022-01-12. End date (EU): 2025-08-13. End date: 2025-08-14. Decision date: 2024-05-14. Results received: No. Last updated: 2024-05-14.

Condition(s): Amyotrophic Lateral Sclerosis (ALS)
Product: 0.9% Sodium Chloride for Injection (Fresenius Kab) sourced locally by sites, AP-101

Primary endpoint: (Double-blind Phase): Incidence of AEs and SAEs including immunogenicity., (Double-blind Phase): Incidence of abnormalities in vital signs, clinical laboratory assessments, physical and neurological examinations, electrocardiograms and changes in weight., (Open-label Extension): Incidence of AEs and SAEs including immunogenicity., (Open-label Extension): Incidence of abnormalities in vital signs, clinical laboratory assessments, physical and neurological examinations, electrocardiograms and changes in weight.
Endpoint(s): (Double-blind Phase): The primary PK parameters are AUC, concentration at the end of infusion and t1/2, (Double-blind Phase): AP-101 levels in the CSF, (Double-blind Phase): Measurement of pNfH and NfL levels in the CSF and plasma after multiple IV doses of AP-101, (Open-label Extension): The primary PK parameters are AUC, concentration at end of infusion and t1/2, (Open-label Extension): Measurement of pNfH and NfL levels in CSF and plasma after multiple IV doses of AP-101

Source: https://euclinicaltrials.eu/ctis-public/view/2024-512343-23-00